EU clinical trial 2024-513864-24-00: A Phase II Study with Sevuparin in Subjects with Chronic Kidney Disease
Protocol code: TCDK01
Sponsor: Modus Therapeutics AB (Pharmaceutical company). Phase: Therapeutic exploratory (Phase II). Countries: Italy (ongoing, recruiting).
Therapeutic area(s): Diseases [C] - Pathological Conditions, Signs and Symptoms [C23]
Gender: Female, Male. Age: 18-64 years, 65+ years. Enrolment: 60.
Status: Ongoing, recruiting. Start date (EU): 2024-11-28. Decision date: 2024-11-12. Results received: No. Last updated: 2025-11-03.

Condition(s): Chronic kidney disease
Product: Sevuparin

Primary endpoint: Part 1: Pharmacokinetic parameters including observed maximal plasma concentration (Cmax), time of maximum observed plasma concentration (tmax), AUC from time zero to the last quantifiable concentration (AUC0-tlast), AUC from time zero to infinity (AUC0-∞), terminal elimination half-life (t1/2λz) and renal clearance (CLR)., Part 2: Assessment of safety parameters including type and severity of adverse events (AEs), electrocardiograms (ECGs), vital signs, clinical laboratory evaluations (serum biochemistry, haematology including reticulocytes and coagulation parameters), urinalysis (dipstick) and physical examinations.
Endpoint(s): Part 1: Assessment of the change from baseline in serum hepcidin. • Assessment of safety parameters including type and severity of AEs, ECGs, vital signs, physical examinations, and clinical laboratory evaluations i.e., serum biochemistry, haematology (including reticulocytes and coagulation parameters) and urinalysis (dipstick)., Part 2: Assessment of the change from baseline in serum hepcidin. Assessment of the change from baseline in haemoglobin (Hb), haematocrit (b-Ht), and reticulocyte haemoglobin (b-RetHb) in blood and serum creatinine (s-Crea). Assessment of PK parameters including Cmax, tmax, AUC0-tlast, AUC0-∞, t1/2λz, plasma accumulation ratio for Cmax and AUC, time to steady state.

Source: https://euclinicaltrials.eu/ctis-public/view/2024-513864-24-00